EU clinical trial 2024-514381-39-00: LEAP2MONO - EFC17215 A phase 3, multicenter, multinational, randomized, double-blind, double-dummy, active-comparator study to evaluate the efficacy and safety of venglustat in adult and pediatric patients with Gaucher disease Type 3 (GD3) who have reached therapeutic goals with Enzyme Replacement Therapy (ERT)
Protocol code: EFC17215 - LEAP2MONO
Sponsor: Sanofi-Aventis Recherche & Developpement (Pharmaceutical company). Phase: Therapeutic confirmatory (Phase III). Countries: Germany (ongoing, recruitment ended), France (ongoing, recruitment ended), Italy (ongoing, recruitment ended).
Therapeutic area(s): Diseases [C] - Congenital, Hereditary, and Neonatal Diseases and Abnormalities [C16]
Gender: Female, Male. Age: 0-17 years, 18-64 years. Enrolment: 15.
Status: Ongoing, recruitment ended. Start date (EU): 2022-12-08. Decision date: 2024-07-31. Results received: No. Last updated: 2026-06-26.
Decision dates by country: FR: 2024-07-31, IT: 2024-08-06, DE: 2024-08-02

Condition(s): Gaucher's disease type III
Product: Cerezyme 400 Units Powder for concentrate for solution for infusion, Placebo 15mg tablets, Cerezyme 400 Units Powder for concentrate for solution for infusion, Placebo for Cerezyme, Cerezyme 400 Units Powder for concentrate for solution for infusion, venglustat GZ402671 - SAR402671, venglustat GZ402671 - SAR402671, Placebo 6mg tablets

Primary endpoint: Change in Scale for Assessment and Rating of Ataxia (SARA) modified total score, Change in Repeatable Battery for the Assessment of Neuropsychological Status (RBANS) total scale index score
Endpoint(s): Percent change in spleen volume, Percent change in liver volume, Change in hemoglobin level, Percent change in platelet count, Percent change in CSF GL-1 and lyso-GL-1 levels, Percent change in plasma GL-1 and lyso-GL-1 levels, Number of patients with treatment emergent adverse events (TEAEs)/ serious adverse events (SAEs)/ adverse events of special interest (AESIs), Change in score of Beck Depression Inventory II (BDI-II) during the treatment-emergent period (for participants 13 years of age and above at baseline), Change in Patient Health Questionnaire 9 (PHQ-9) during the treatment-emergent period (for participants 12 years of age at baseline)

Source: https://euclinicaltrials.eu/ctis-public/view/2024-514381-39-00